EU clinical trial 2024-514516-27-00: A Randomized, Open-label, Phase 2 Trial of Ponatinib in Patients with Resistant Chronic Phase Chronic Myeloid Leukemia to Characterize the Efficacy and Safety of a Range of Doses
Protocol code: AP24534-14-203
Sponsor: Takeda Development Center Americas Inc. (Pharmaceutical company). Phase: Therapeutic exploratory (Phase II). Countries: Poland (ended), France (ended).
Therapeutic area(s): Diseases [C] - Hemic and Lymphatic Diseases [C15]
Gender: Female, Male. Age: 18-64 years, 65+ years. Enrolment: 2.
Status: Ended. Start date (EU): 2015-12-01. End date (EU): 2025-04-23. End date: 2025-04-24. Decision date: 2024-10-03. Results received: Yes. Last updated: 2025-02-25.
Decision dates by country: FR: 2024-10-03, PL: 2024-10-09

Condition(s): Chronic Phase Chronic Myeloid Leukemia
Product: Iclusig 30 mg film-coated tablets, Iclusig 45 mg film-coated tablets, Iclusig 45 mg film-coated tablets, Iclusig 15 mg film-coated tablets, Iclusig 15 mg film-coated tablets, Iclusig 15 mg film-coated tablets, Ponatinib

Primary endpoint: 01. ≤ 1% BCR-ABL1IS at 12 months for each starting dose cohort.
Endpoint(s): 01. Molecular response rates: MMR at 12 and 24 months, 02. Cytogenetic response rates: MCyR by 12 months, 03. Duration of MMR, 04. Safety a.Rate of AOEs and VTEs in each dose cohort b.Rate of AEs in each dose cohort c.Rate of SAEs in each dose cohort, 05. Cytogenetic response rates: CCyR at 12 months, 06. Molecular response rates: MR4, and MR4.5 by and at 3-month intervals and MR1 (≤ 10% BCR-ABL1IS) at 3 months, 07. Hematologic response rate: Complete hematologic response (CHR) at 3 months, 08. Tolerability: a.Rate of discontinuation due to AEs in each dose cohort b.Dose reductions due to AE in each dose cohort c.Dose interruptions in each dose cohort, 09. Duration of response: a.Rate of ≤1% BCR-ABL1IS by 12 months and at and by 6, 18, and 24 months b.MMR at and by 6 and 18 months; and by 12 and 24 months, 10. Duration of response in responders, 11. Time to response, 12. Rate of progression to accelerated phase (AP-) or blast phase (BP-) CML, 13. PFS, 14. OS

Source: https://euclinicaltrials.eu/ctis-public/view/2024-514516-27-00